EU clinical trial 2024-520148-40-00: First time in human clinical test using a personalized tissue-engineered blood vessel to treat chronical illness in a vein.
Protocol code: TECVI-1
Sponsor: VeriGraft AB (Pharmaceutical company). Phase: Human Pharmacology (Phase I)- First administration to humans. Countries: Spain (ended).
Therapeutic area(s): Diseases [C] - Cardiovascular Diseases [C14]
Gender: Female, Male. Age: 18-64 years, 65+ years. Enrolment: 15.
Status: Ended. Start date (EU): 2021-02-25. End date (EU): 2025-06-11. Decision date: 2024-12-23. Results received: No. Last updated: 2025-05-14.

Condition(s): Chronic venous insufficiency

Source: https://euclinicaltrials.eu/ctis-public/view/2024-520148-40-00